EU clinical trial 2025-522642-44-00: B7981118 - A Phase 2b Randomized, Double Blind, 12-Week Placebo Controlled Study With a 12-Week Double-Blind Extension Period to Evaluate the Efficacy, Safety and Tolerability of Ritlecitinib (PF 06651600) in Adult Participants with Chronic Spontaneous Urticaria
Protocol code: B7981118
Sponsor: Pfizer Inc. (Pharmaceutical company). Phase: Therapeutic exploratory (Phase II). Countries: Spain (ongoing, recruiting), Germany (ongoing, recruiting), Bulgaria (ongoing, recruiting), Poland (ongoing, recruiting).
Therapeutic area(s): Diseases [C] - Skin and Connective Tissue Diseases [C17]; Diseases [C] - Immune System Diseases [C20]
Gender: Female, Male. Age: 18-64 years, 65+ years. Enrolment: 46.
Status: Ongoing, recruiting. Start date (EU): 2026-03-18. Decision date: 2026-02-25. Results received: No. Last updated: 2026-07-22.
Decision dates by country: BG: 2026-03-02, DE: 2026-02-25, ES: 2026-03-04, PL: 2026-03-07

Condition(s): CHRONIC SPONTANEOUS URTICARIA
Product: Placebo for pf-06651600-15, 50 mg, Placebo for pf-06651600-15, 100 mg, Ritlecitinib tosilate, LORATADINE, Ritlecitinib Tosilate

Primary endpoint: Change from baseline in UAS7 at Week 12, Incidence of TEAEs, SAEs, and AEs leading to discontinuation
Endpoint(s): Change from baseline in UAS7 at all timepoints except Week 12, Change from baseline in ISS7 at Week 12, Change from baseline in HSS7 at Week 12, Achieving complete response defined as UAS7=0 at Week 12, Achieving UAS7 ≤6 at Week 12, Achieving complete response defined as ISS7=0 at Week 12, Achieving complete response defined as HSS7=0 at Week 12, Time to achieving UAS7 ≤6, Time to achieving improvement from baseline ≥10 in UAS7, Incidence of TEAEs, SAEs, and AEs leading to discontinuation

Source: https://euclinicaltrials.eu/ctis-public/view/2025-522642-44-00